EU clinical trial 2025-522114-23-00: A Phase II, Open-label, Multicenter Study Testing Teclistamab in Combination with Pomalidomide Administered in Alternative Fashion in Participants with RRMM, who Received 1 - 3 Prior Lines of Therapy, Including Lenalidomide and Anti-CD38 Therapy
Protocol code: 64007957MMY2022
Sponsor: Odense University Hospital (Hospital/Clinic/Other health care facility). Phase: Therapeutic exploratory (Phase II). Countries: Finland (authorised, recruitment pending), Denmark (authorised, recruitment pending), Estonia (authorised, recruitment pending), Norway (authorised, recruitment pending).
Therapeutic area(s): Diseases [C] - Neoplasms [C04]
Gender: Female, Male. Age: 18-64 years, 65+ years. Enrolment: 50.
Status: Authorised, recruitment pending. Decision date: 2026-06-15. Results received: No. Last updated: 2026-06-22.
Decision dates by country: DK: 2026-06-15, EE: 2026-06-22, FI: 2026-06-15, NO: 2026-06-15

Condition(s): Multiple myeloma (RRMM)
Product: teclistamab, Imnovid 2 mg hard capsules, teclistamab

Primary endpoint: PFS at 12 months (12 cycles)
Endpoint(s): MRD negative with CR after 12 cycles, MRD negative with CR after 24 cycles, PFS overall, ORR (PR or better), VGPR or better, CR or better, Duration of response, Time to response, OS, Incidence and severity of AEs, Grade 3 or 4 infections, infection rate, serious AEs, AE Grade5/deaths and reasons, AEs causing treatment withdrawal or hospitalization and laboratory results, Change from baseline in symptoms, functioning, and overall HRQoL where baseline is defined as the latest measurement before the first dose of study treatment., Time to worsening in symptoms, functioning, and overall HRQoL.

Source: https://euclinicaltrials.eu/ctis-public/view/2025-522114-23-00